EU clinical trial 2023-507564-39-00: Study of TSR-022, a Monoclonal Antibody, in Patients with Advanced Solid Tumors
Protocol code: AMBER
Sponsor: Tesaro Inc. (Pharmaceutical company). Phase: Human Pharmacology (Phase I)- First administration to humans. Countries: Spain (ongoing, recruitment ended).
Therapeutic area(s): Diseases [C] - Neoplasms [C04]
Gender: Female, Male. Age: 18-64 years, 65+ years. Enrolment: 1221.
Status: Ongoing, recruitment ended. Start date (EU): 2019-03-11. Decision date: 2024-01-30. Results received: No. Last updated: 2026-06-11.

Condition(s): Patients with Advanced Solid Tumors

Source: https://euclinicaltrials.eu/ctis-public/view/2023-507564-39-00